EU clinical trial 2024-517141-13-00: A Study of Oral Tazemetostat in Subjects With Moderate and Severe Liver Impairment With Advanced solid tumors or hematological malignancies
Protocol code: EZH-1201
Sponsor: Epizyme Inc. (Pharmaceutical company). Phase: Human Pharmacology (Phase I)- Other. Countries: Belgium (ended), Poland (ended), Slovakia (ended), France (ended).
Therapeutic area(s): Diseases [C] - Neoplasms [C04]
Gender: Female, Male. Age: 18-64 years, 65+ years. Enrolment: 19.
Status: Ended. Start date (EU): 2020-10-07. End date (EU): 2026-03-06. End date: 2026-03-07. Decision date: 2024-10-17. Results received: No. Last updated: 2025-09-08.
Decision dates by country: BE: 2024-10-17, FR: 2024-10-18, PL: 2024-10-21, SK: 2024-10-18

Condition(s): Advanced solid tumors, or hematological malignancies and normal hepatic function or moderate, or severe hepatic impairment.

Source: https://euclinicaltrials.eu/ctis-public/view/2024-517141-13-00